EU clinical trial 2024-519521-37-01: Optimizing Reperfusion to Improve Outcomes and Neurologic Function (ORION) A Multicenter, Double-Blind, Placebo-Controlled, Randomized, Parallel-Group, Phase 2 3 Study to Evaluate the Efficacy and Safety of JX10 in Acute Ischemic Stroke with Late Presentations
Protocol code: JX10002
Sponsor: Corxel Pharmaceuticals Co. Ltd. (Pharmaceutical company). Phase: Phase II and Phase III (Integrated). Countries: Spain (ongoing, recruiting), Finland (ended), Italy (authorised, recruiting), Bulgaria (ongoing, recruiting), Poland (authorised, recruiting), Germany (ongoing, recruiting), Hungary (ongoing, recruiting), Belgium (authorised, recruiting), Greece (ongoing, recruiting), Lithuania (ongoing, recruiting), Portugal (authorised, recruiting), Latvia (ongoing, recruiting), France (authorised, recruiting).
Therapeutic area(s): Diseases [C] - Nervous System Diseases [C10]
Gender: Female, Male. Age: 18-64 years, 65+ years. Enrolment: 287.
Start date (EU): 2025-07-30. Decision date: 2025-06-23. Results received: No. Last updated: 2026-06-12.
Decision dates by country: HU: 2025-09-29, IT: 2025-07-04, BE: 2025-09-08, PL: 2025-07-04, GR: 2025-08-20, LT: 2025-10-02, BG: 2025-07-04, PT: 2025-09-16, LV: 2025-10-12, ES: 2025-07-04, DE: 2025-07-04, FR: 2025-09-30, FI: 2025-07-04

Condition(s): Acute ischemic stroke
Product: JX10, Jx10 placebo drug product is prepared as a sterile, lyophilized white to light yellow cake or powder for infusion.

Primary endpoint: Efficacy: Proportion of participants with no or minimal symptoms at 90 days., Safety: Incidence of symptomatic intracranial hemorrhage, defined as local or remote parenchymal hemorrhage type 2, subarachnoid hemorrhage, and or intraventricular hemorrhage within 36 hours post-randomization, combined with a neurological deterioration of 4 points or more on the NIHSS from baseline (the closest collection before administration of the study treatment), or from the lowest NIHSS value between baseline and 24 hours, or leading to death.

Source: https://euclinicaltrials.eu/ctis-public/view/2024-519521-37-01